EU clinical trial 2024-518890-33-00: Body Weight Adjusted Clopidogrel treatment in patients with CORonary artery Disease (BW-ACCORD)
Sponsor: Sint Antonius Ziekenhuis Stichting (Hospital/Clinic/Other health care facility). Phase: Therapeutic use (Phase IV). Countries: Netherlands (ongoing, recruiting).
Therapeutic area(s): Diseases [C] - Cardiovascular Diseases [C14]
Gender: Female, Male. Age: 18-64 years, 65+ years. Enrolment: 80.
Status: Ongoing, recruiting. Start date (EU): 2024-11-12. Decision date: 2024-11-12. Results received: No. Last updated: 2024-11-12.

Condition(s): Chronic coronary syndrome
Product: Efient 10 mg film-coated tablets., Plavix 75 mg film-coated tablets

Primary endpoint: Level of platelet reactivity, measured as Platelet Reaction Unit, as measured by the VerifyNow system
Endpoint(s): To determine if the CYP2C19 genotype has additional effect on the platelet reactivity in the different treatment groups., To assess the difference between PRU values in the high bodyweight/BMI group during clopidogrel treatment and prasugrel treatment., To assess possible confounders for HTPR., Mortality (and cause of mortality), Myocardial infarction, Stent thrombosis, Revascularization, Stroke, Bleedings, To correlate the measured body fat percentages with PRU values.

Source: https://euclinicaltrials.eu/ctis-public/view/2024-518890-33-00